EU clinical trial 2025-523863-39-00: Changes in the wound microbiome and their impact on chronic wound healing under hyperbaric conditions
Sponsor: Medical University Of Graz (Educational Institution). Phase: Therapeutic use (Phase IV). Countries: Austria (ongoing, recruiting).
Therapeutic area(s): Diseases [C] - Skin and Connective Tissue Diseases [C17]; Phenomena and Processes [G] - Microbiological Phenomena [G06]; Phenomena and Processes [G] - Cell Physiological Phenomena [G04]; Diseases [C] - Bacterial Infections and Mycoses [C01]; Diseases [C] - Pathological Conditions, Signs and Symptoms [C23]; Diseases [C] - Immune System Diseases [C20]
Gender: Female, Male. Age: 18-64 years, 65+ years. Enrolment: 80.
Status: Ongoing, recruiting. Start date (EU): 2026-03-05. Decision date: 2026-02-16. Results received: No. Last updated: 2026-05-06.

Condition(s): chronic wounds
Product: Sauerstoff medizinisch Air Liquide

Primary endpoint: The primary endpoint will be the between-group difference in wound microbiome alpha-diversity at the prespecified primary evaluation time point Week 6 (end of the 6-week HBOT intervention period), quantified by the Shannon diversity index (confirmatory primary endpoint)., microbial diversity and composition within the wound microbiome will be assessed longitudinally before, during, and after the HBOT treatment period
Endpoint(s): • Clinical wound healing indicators (e.g., wound size reduction, infection rates, tissue regeneration quality)., • A structured biobank of microbiome samples and metadata from chronic wounds to enable future research on wound healing, resistance mechanisms, and HBOT-related microbial responses., • Patient-reported outcomes on quality of life and wound-related pain or discomfort., • Cost-effectiveness assessment of HBOT relative to conventional wound care.

Source: https://euclinicaltrials.eu/ctis-public/view/2025-523863-39-00